EU clinical trial 2022-502737-26-00: Etude évaluant l’imagerie proche infrarouge couplée au vert d’indocyanine pour le contrôle peropératoire des marges de résection en chirurgie ORL (MAGNOLIA)
Sponsor: Institut Gustave Roussy (Hospital/Clinic/Other health care facility). Phase: Therapeutic exploratory (Phase II). Countries: France (ongoing, recruiting), Belgium (ongoing, recruiting).
Therapeutic area(s): Diseases [C] - Skin and Connective Tissue Diseases [C17]
Gender: Female, Male. Age: 18-64 years, 65+ years. Enrolment: 65.
Status: Ongoing, recruiting. Start date (EU): 2020-12-15. Decision date: 2023-03-06. Results received: No. Last updated: 2025-05-06.
Decision dates by country: FR: 2023-03-06, BE: 2023-12-11

Condition(s): epidermoid carcinoma
Product: INFRACYANINE 25 mg/10 mL, poudre et solvant pour solution injectable

Primary endpoint: Sensitivity of real-time near-infrared fluorescence imaging in the first and last sections in which pathological examination confirms the presence of microscopic residual disease after complete gross surgical resection.
Endpoint(s): Specificity of real-time near-infrared fluorescence imaging to detect healthy margins in real time. - Positive predictive value of real-time near-infrared fluorescence imaging to detect microscopic residual disease in the surgical bed after resection. - Tumor to background ratio (TBR) mapping and kinetics - Number of patients with adverse events and their grade to measure safety and tolerability

Source: https://euclinicaltrials.eu/ctis-public/view/2022-502737-26-00